EU clinical trial 2024-515183-30-00: APECS II: Comparing the efficacy of Pectoral Nerve (PECS II) Block with long-acting liposomal bupivacaine versus levobupivacaine for Mastectomy Surgery: A Multicenter Prospective Randomized Controlled Trial
Protocol code: NL83450.100.23
Sponsor: St. Antonius Ziekenhuis (Hospital/Clinic/Other health care facility). Phase: Therapeutic confirmatory (Phase III). Countries: Netherlands (authorised, recruitment pending).
Therapeutic area(s): Analytical, Diagnostic and Therapeutic Techniques and Equipment [E] - Anesthesia and Analgesia [E03]; Diseases [C] - Neoplasms [C04]
Gender: Female. Age: 18-64 years, 65+ years. Enrolment: 130.
Status: Authorised, recruitment pending. Decision date: 2024-06-18. Results received: No. Last updated: 2024-06-18.

Condition(s): Postoperative and chronic pain after breast cancer surgery
Product: EXPAREL liposomal 133 mg/10 mL prolonged-release dispersion for injection, Levobupivacaïne Fresenius Kabi 5 mg/ml, oplossing voor injectie/infusie, Bupivacaïne Eugia 5 mg/ml, oplossing voor injectie

Primary endpoint: Postoperative NRS pain scores in the breast.
Endpoint(s): Postoperative NRS pain scores in the axilla., Intraoperative need of opiates (milligrams)., Postoperative need of opiates or other pain killers (milligrams)., Patient-reported chronic (> 12 weeks) pain (yes/no)., Patient satisfaction, measured by the BREAST-Q BCT., Postoperative time that patients need to be observed in the recovery room (minutes)., Time until patients are discharged from the hospital (hours)., Use of additional anti-emetics for PONV (yes/no)., Vomiting (yes/no)., Complications (wound infection rate, hematoma, abscess, pneumothorax, local anesthesia systemic toxicity).

Source: https://euclinicaltrials.eu/ctis-public/view/2024-515183-30-00